EU clinical trial 2024-518663-35-00: Open label randomized phase II/III trial of dendritic cell immunotherapy against cancer stem cells in glioblastoma patients receiving standard therapy (DEN-STEM)
Protocol code: DEN-STEM
Sponsor: Oslo University Hospital HF (Hospital/Clinic/Other health care facility). Phase: Phase II and Phase III (Integrated). Countries: Norway (ongoing, recruiting).
Therapeutic area(s): Diseases [C] - Neoplasms [C04]
Gender: Female, Male. Age: 18-64 years, 65+ years. Enrolment: 60.
Status: Ongoing, recruiting. Start date (EU): 2018-04-25. Decision date: 2024-10-30. Results received: No. Last updated: 2026-01-12.

Condition(s): Glioblastoma
Product: Autologous cancer stem cell mRNA transfected dendritic cells

Primary endpoint: Progression free survival - Defined as time from first surgery to first certain progress of contrast enhancing tumor or clinical progression, according to the Response Assessment in Neuro-Oncology (RANO) criteria. Assessment of objective tumor response includes an evaluation by MRI at the start of vaccination, at week 25 and thereafter every 3 months., As contrast enhancement may vary over time, due to pseudoprogression and may be affected through the course of the immune-therapy, the definite time of progression may be corrected after overall survival has been reached.

Source: https://euclinicaltrials.eu/ctis-public/view/2024-518663-35-00